EU clinical trial 2023-509829-52-00: A phase IV study of Faricimab to explore associations of visual acuity benefits and changes in vascular integrity using adaptive optics in patients with diabetic macular edema
Protocol code: KKSH193
Sponsor: Martin-Luther-Universitaet Halle-Wittenberg (Educational Institution). Phase: Therapeutic use (Phase IV). Countries: Germany (ongoing, recruiting).
Therapeutic area(s): Diseases [C] - Eye Diseases [C11]
Gender: Female, Male. Age: 18-64 years, 65+ years. Enrolment: 133.
Status: Ongoing, recruiting. Start date (EU): 2025-09-01. Decision date: 2025-06-26. Results received: No. Last updated: 2026-02-26.

Condition(s): Macular edema
Product: Vabysmo 120 mg/mL solution for injection

Primary endpoint: Improvement of visual acuity, measured by change in BCVA (metric variable). BCVA (as measured as letters on the ETDRS chart at a starting distance of 4 m) will be collected from each individual patients of group 1a and group 1b at baseline and at 12 months
Endpoint(s): Number of injections during the 12 months therapy on a Q4W, Q8W, Q12W, or Q16W treatment interval at 12 months, To evaluate the efficacy of Faricimab on anatomical outcomes using SD-OCT as a clinically relevant parameter for the decision of the treat and extend scheme (T&E). Corresponding secondary endpoints: ● Change from baseline to at 12 months ● absence of DME (CST <325 μm) to at 12 months ● absence of IRF (intra-retinal fluid) to at 12 months ● absence of SRF (sub-retinal fluid) to at 12 months ● absence of IRF and SRF to at 12 months, ● Change from baseline in BCVA over time ● gaining ≥10, ≥5, or ≥0 ETDRS letters in BCVA from at baseline to at 12 month ● avoiding a loss of ≥15, ≥10, or ≥5 ETDRS letters in BCVA from at baseline to at 12 month ● gaining ≥15 ETDRS letters from at baseline or achieving BCVA of ≥84 ETDRS letters to at 12 month, ● BCVA Snellen equivalent of 20/40 (BCVA ≥69 ETDRS letters) or better to at 12 months ● BCVA Snellen equivalent of 20/200 (BCVA ≤38 ETDRS letters) or worse to at 12 months ● Improved vision measured by Adaptive Sensory Technology (AST) for contrast sensitivity and visual acuity, ● longitudinal WLR measurements from at baseline (first visit) to at 12 months) ● gaining WLR >0.1 or >0.5 or <0.1 from at baseline to at 12 month ● Mean WLR at baseline in group 1a significant different from mean WLR at 12 months ● Mean WLR at baseline in group 1b significant different from mean WLR at 12 months, ● Change from baseline in FAZ (in µm2) to at 12 months ● >10% reduction of the FAZ to at 12 month, Quantification of countable area size in mm2 and photoreceptor density (cones per mm2) by AO at an edema border. ● Change of area size mm2 (focused countable cones per mm2 in a defined retinal area) from baseline to at 12 month ● Change from baseline of photoreceptor density (cones per mm2) to at 12 month

Source: https://euclinicaltrials.eu/ctis-public/view/2023-509829-52-00